EU clinical trial 2024-512311-41-00: Randomised, bioequivalence clinical trial of rasagiline 1 mg capsules vs rasagiline 1 mg tablets, after a single oral dose administration to healthy volunteers under fasting conditions in crossover replicated design.
Protocol code: UECHUP-RAS/24-2
Sponsor: Laboratorios Alter S.A. (Pharmaceutical company). Phase: Human Pharmacology (Phase I)- Bioequivalence Study. Countries: Spain (ended).
Therapeutic area(s): Diseases [C] - Nervous System Diseases [C10]
Gender: Female, Male. Age: 18-64 years. Enrolment: 48.
Status: Ended. Start date (EU): 2024-06-03. End date (EU): 2024-07-19. Decision date: 2024-05-27. Results received: No. Last updated: 2024-06-13.

Condition(s): Parkinson´s disease

Source: https://euclinicaltrials.eu/ctis-public/view/2024-512311-41-00